EU clinical trial 2024-514113-35-01: Multicenter randomized clinical trial to evaluate two different amiodarone regimens to maintain sinus rhythm after cardioversion in persistent atrial fibrillation (PERIVERSION-2).
Protocol code: IIBSP-AMI-2024-33
Sponsor: Fundacio Institut De Recerca De L Hospital De La Santa Creu I Sant Pau (Hospital/Clinic/Other health care facility). Phase: Therapeutic use (Phase IV). Countries: Spain (ongoing, recruiting).
Therapeutic area(s): Diseases [C] - Cardiovascular Diseases [C14]
Gender: Female, Male. Age: 18-64 years, 65+ years. Enrolment: 312.
Status: Ongoing, recruiting. Start date (EU): 2025-11-03. Decision date: 2025-01-27. Results received: No. Last updated: 2025-01-27.

Condition(s): Persistent atrial fibrillation
Product: Amiodarone hydrochloride 200 mg tablets

Primary endpoint: First recurrence of AF (requires ECG) after randomization.
Endpoint(s): Assessment of adverse effects, which will be determined by specific criteria including TSH levels below 0.1 microUI/ml, TSH levels exceeding 4.2 microUI/ml, a threefold increase in AST, ALT, or GGT compared to baseline levels, a QTc interval exceeding 500 ms or any other adverse effects as per the drug technical sheet., Study of polymorphisms in CYP2D6, CYP2C19, CYP1A2, CYP2C8, CYP3A4, and ABCB1., Plasma levels of amiodarone during follow-up, Correlate polymorphisms, with plasma levels, safety and efficacy.

Source: https://euclinicaltrials.eu/ctis-public/view/2024-514113-35-01